EU clinical trial 2023-509881-39-00: Lutetium-177-PSMA in Oligo-metastatic Hormone Sensitive Prostate Cancer.
Sponsor: Stichting Radboud University Medical Center (Patient organisation/association). Phase: Therapeutic exploratory (Phase II). Countries: Cyprus (ended), Netherlands (ended).
Therapeutic area(s): Diseases [C] - Male Urogenital Diseases [C12]; Diseases [C] - Neoplasms [C04]
Gender: Male. Age: 18-64 years, 65+ years. Enrolment: 58.
Status: Ended. Start date (EU): 2020-07-27. End date (EU): 2026-01-19. Decision date: 2024-07-22. Results received: No. Last updated: 2024-07-31.
Decision dates by country: CY: 2024-07-31, NL: 2024-07-22

Condition(s): prostate cancer
Product: 18F-PSMA-1007, Pluvicto 1 000 MBq/mL solution for injection/infusion

Primary endpoint: The main study parameters are the fractions of patients that have disease progression (as a surrogate for progression free survival defined in paragraph 2: objectives) within 6-month follow up in the two arms, A second main study parameter is the time to disease progression and meeting EOT 1 criteria in both groups
Endpoint(s): Secondary endpoints will be the ADT free survival, PSA response, toxicity defined by NCI Common Terminology Criteria for Adverse Events (CTCAE v5.0), radiological state of the disease expressed in the difference in amount and size of suspicious nodes 18F-PSMA PET/(diagnostic) CT and (whole body) MRI between pre- and post-therapy and quality of life assessments, in both arms

Source: https://euclinicaltrials.eu/ctis-public/view/2023-509881-39-00